EU clinical trial 2024-517233-40-00: Antibiotic treatment following surgical drainage of perianal abscess: a double-blind, placebo-controlled, randomized trial
Protocol code: 80-86600-98-19047
Sponsor: Amsterdam UMC Stichting, Proctos kliniek (Hospital/Clinic/Other health care facility, Health care). Phase: Therapeutic use (Phase IV). Countries: Netherlands (authorised, recruitment pending).
Therapeutic area(s): Diseases [C] - Digestive System Diseases [C06]
Gender: Female, Male. Age: 18-64 years, 65+ years. Enrolment: 298.
Status: Authorised, recruitment pending. Decision date: 2024-11-11. Results received: No. Last updated: 2024-11-11.

Condition(s): Perianal abscess
Product: Metronidazol Aurobindo 500 mg, filmomhulde tabletten, Ciprofloxacine Teva 500 mg filmomhulde tabletten, Placebo tablets, Tiofarma B.V.,

Primary endpoint: Development of a perianal fistula within one year.
Endpoint(s): Quality of life at 12 months, Costs and cost-effectiveness, Need of repeated drainage, Recurrent abscess, Complications, Patient reported outcomes measures, Length of hospital stay, Readmissions, Time till return to work

Source: https://euclinicaltrials.eu/ctis-public/view/2024-517233-40-00